EU clinical trial 2023-508338-33-00: A Phase 3, randomized, double-blind study evaluating efficacy and safety of riliprubart versus intravenous immunoglobulin (IVIg) in participants with chronic inflammatory demyelinating polyneuropathy
Protocol code: EFC18156
Sponsor: Sanofi-Aventis Recherche & Developpement (Pharmaceutical company). Phase: Therapeutic confirmatory (Phase III). Countries: Czechia (ongoing, recruiting), Sweden (ongoing, recruiting), Germany (ongoing, recruiting), Belgium (ongoing, recruiting), France (ongoing, recruiting), Denmark (ongoing, recruiting), Hungary (ongoing, recruiting), Portugal (ongoing, recruiting), Spain (ongoing, recruiting), Italy (authorised, recruitment pending), Greece (authorised, recruitment pending), Poland (authorised, recruitment pending), Norway (authorised, recruitment pending).
Therapeutic area(s): Diseases [C] - Immune System Diseases [C20]
Gender: Female, Male. Age: 18-64 years, 65+ years. Enrolment: 113.
Start date (EU): 2024-10-01. Decision date: 2024-07-15. Results received: No. Last updated: 2026-07-07.
Decision dates by country: DK: 2024-07-16, BE: 2024-07-22, IT: 2025-11-21, SE: 2024-07-19, FR: 2024-07-17, GR: 2026-01-14, PL: 2026-02-08, NO: 2026-01-20, CZ: 2024-07-17, ES: 2024-07-15, HU: 2024-07-16, DE: 2024-07-19, PT: 2024-07-16

Condition(s): Chronic Inflammatory Demyelinating Polyneuropathy
Product: placebo matching IVIg, riliprubart placebo solution for injection in vial, riliprubart, riliprubart, riliprubart placebo solution for injection in prefilled pen

Primary endpoint: Percentage of participants experiencing a response, Percentage of participants randomized to riliprubart who responded during part A and had a lasting response during the open-label treatment extension period.
Endpoint(s): Change from baseline in Rasch-built Overall Disability Scale (I-RODS) score, Change from baseline in adjusted inflammatory neuropathy cause and treatment (INCAT) disability score, Change from baseline in grip strength (kilopascals, dominant hand), Change from baseline in Medical Research Council Sum Score (MRC-SS), Change from baseline in the Rasch-built modified fatigue severity scale (RT-FSS), Percentage of participants experiencing a relapse, Change from baseline in the EuroQol 5 Dimension, 5-Level Health Scale (EQ-5D-5L), Number of participants with TEAEs, including SAEs and AESIs for Part A., Number of participants with treatment-emergent ADA in participants treated with riliprubart, Number of participants with TEAEs, including SAEs and AESIs, Percentage of participants randomized to riliprubart experiencing a relapse, Percentage of participants randomized to IVIg continuation experiencing a relapse, Incidence and titer of anti-drug antibodies (ADA) during open-label treatment and follow-up., Change from baseline in I-RODS, Change from baseline in adjusted INCAT score, Change from baseline in grip strength (kilopascals; dominant hand), Change from baseline in MRC-SS, Change from baseline in RT-FSS, Change from baseline in EQ-5D-5L score, Percentage of participants randomized to riliprubart who experienced a response at Week 48 without prior response in Part A (delayed response), Percentage of participants randomized to IVIg continuation who experience a response

Source: https://euclinicaltrials.eu/ctis-public/view/2023-508338-33-00